EU clinical trial 2024-513947-94-00: ABP - Advancing Brigatinib Properties in anaplastic lymphoma kinase positive non-small cell lung cancer (ALK+ NSCLC) patients by deep phenotyping
Protocol code: ABP-2019
Sponsor: Frankfurter Institut Fuer Klinische Krebsforschung IKF GmbH (Pharmaceutical company). Phase: Therapeutic exploratory (Phase II). Countries: Germany (ended).
Therapeutic area(s): Diseases [C] - Neoplasms [C04]
Gender: Female, Male. Age: 18-64 years, 65+ years. Enrolment: 118.
Status: Ended. Start date (EU): 2020-03-30. End date (EU): 2026-05-30. Decision date: 2024-10-23. Results received: No. Last updated: 2025-12-17.

Condition(s): locally advanced (stage III) and not suitable for curative treatment, or metastatic (stage IV) ALK+ NSCLC, ALK+ NSCLC
Product: Alunbrig 30 mg film-coated tablets, CRIZOTINIB, LORLATINIB, Zykadia 150 mg hard capsules, ALECTINIB

Primary endpoint: PFS 1st-line treatment assessed by applying RECIST v1.1
Endpoint(s): PFS 2nd-line treatment (RECIST v1.1), TNT 1st line (TNT1, i.e. time-to-next treatment for the 1st line, defined as the time from begin of 1st-line treatment until begin of 2nd-line treatment), TNT 2nd line (TNT2, i.e. time-to-next treatment for the 2nd line, defined as time from begin of 2nd line until begin of 3rd-line treatment), TNT1/2 (time-to-next treatmemt for the 1st and 2nd line together, defined as time from begin of 1st-line treatment until begin of 3rd-line treatment), Overall survival (OS), defined as the time from treatment start in the 1st line to the date of death (due to any cause), Efficacy in the CNS (“brain control”) of 1st- and 2nd-line treatment assessed by applying RECIST v1.1 criteria, QoL assessed with SF-12 and EORTC-QLQ-BN20, Safety and tolerability including type, incidence and severity of AEs, SAEs, Exploratory endpoint: Capturing ALK fusion variants, TP53 mutation status and „acquired resistance“ mutations via standardized NGS-based multiplex analysis, Exploratory endpoint: Efficacy of treatment according to ALK fusion variant and TP53 status, Exploratory endpoint: Molecular resistance patterns after 1st-line failure, Exploratory endpoint: Impact of 2nd-line treatment after failure of 1st line as defined, Exploratory endpoint: Clinical utility of cerebrospinal fluid ctDNA analysis in “brain-only” progression

Source: https://euclinicaltrials.eu/ctis-public/view/2024-513947-94-00